EU clinical trial 2023-509574-34-00: A placebo-controlled safety and tolerability study of intravenous (IV) and subcutaneous (SC) AZD1163 in healthy volunteers
Protocol code: D9640C00001
Sponsor: AstraZeneca AB (Pharmaceutical company). Phase: Human Pharmacology (Phase I)- First administration to humans. Countries: Germany (ended).
Therapeutic area(s): Diseases [C] - Immune System Diseases [C20]
Gender: Female, Male. Age: 18-64 years. Enrolment: 29.
Status: Ended. Start date (EU): 2024-04-10. End date (EU): 2025-07-16. End date: 2026-01-13. Decision date: 2024-04-04. Results received: No. Last updated: 2025-01-31.
Decision dates by country: DE: 2024-05-17

Condition(s): Rheumatoid Arthritis

Source: https://euclinicaltrials.eu/ctis-public/view/2023-509574-34-00